EU clinical trial 2024-515216-46-00: Evaluation of frequency occurrence persistent pulmonary hypertension of newborns in group of newborns born between 32 and 42 weeks of pregnancy treated by salbutamol
Protocol code: REFSAL
Sponsor: Medical University Of Warsaw (Educational Institution). Phase: Phase III and phase IV (Integrated). Countries: Poland (ended).
Therapeutic area(s): Diseases [C] - Respiratory Tract Diseases [C08]
Gender: Female, Male. Age: 0-17 years. Enrolment: 608.
Status: Ended. Start date (EU): 2021-11-15. End date (EU): 2025-11-04. Decision date: 2024-12-16. Results received: No. Last updated: 2024-12-16.

Condition(s): Breathing disorders as a cause of neonatal respiratory failure
Product: SALBUTAMOL, Natrium chloratum 0,9% Kabi, 9 mg/ml, rozpuszczalnik do sporzqdzania lekow parenteralnych

Primary endpoint: Assessment of the incidence of PPHN defined as the need for ventilation with additional oxygen fraction in the respiratory mixture (FiO2) > 0. 30 and echocardiographic features of elevated pulmonary pressure or the difference in pre and postprandial saturation > 10%
Endpoint(s): 1. Scoring on the TTN score., 2. Prevalence of failures defined as the need for intubation., 3. Duration of respiratory support., 4. Hospitalisation time., 5. Results of the acid-base balance (ABS) and ionogram., 6. Occurrence of Adverse Events.

Source: https://euclinicaltrials.eu/ctis-public/view/2024-515216-46-00